EU clinical trial 2025-524299-44-00: First study evaluating the safety and dosage of YG-01 in patients with a malignant brain tumor
Protocol code: YG-01-101
Sponsor: Ygion Biomedical GmbH (Pharmaceutical company). Phase: Human Pharmacology (Phase I)- First administration to humans. Countries: Austria (authorised, recruitment pending).
Therapeutic area(s): Diseases [C] - Neoplasms [C04]
Gender: Female, Male. Age: 18-64 years, 65+ years. Enrolment: 15.
Status: Authorised, recruitment pending. Decision date: 2026-06-29. Results received: No. Last updated: 2026-06-29.

Condition(s): Glioblastoma

Source: https://euclinicaltrials.eu/ctis-public/view/2025-524299-44-00